EU clinical trial 2023-506128-10-00: Clear-Brain: stimulating amyloid clearance in cerebral amyloid angiopathy
Sponsor: Academisch Ziekenhuis Leiden (Hospital/Clinic/Other health care facility). Phase: Therapeutic exploratory (Phase II). Countries: Netherlands (ongoing, recruiting).
Therapeutic area(s): Diseases [C] - Nervous System Diseases [C10]; Phenomena and Processes [G] - Physiological processes [G07]
Gender: Female, Male. Age: 18-64 years, 65+ years. Enrolment: 60.
Status: Ongoing, recruiting. Start date (EU): 2025-03-27. Decision date: 2024-04-08. Results received: No. Last updated: 2026-01-30.

Condition(s): Cerebral amyloid angiopathy
Product: SODIUM OXYBATE

Primary endpoint: The primary endpoint will be the morning Aβ 40 and 42 levels in CSF before and after treatment. CSF will be obtained through a lumbar puncture before the intervention at 3 months and after the intervention at 6 months.

Source: https://euclinicaltrials.eu/ctis-public/view/2023-506128-10-00